EU clinical trial 2024-514953-31-00: A Phase II, Multicenter, Randomized Study of Cetuximab Plus/Minus Weekly Paclitaxel After Progression To First-Line Pembrolizumab Plus Platinum-5FU in Subjects with Recurrent/Metastatic Squamous Cell Carcinoma of the Head and Neck (ERBIOTAX)
Protocol code: TTCC-2022-02
Sponsor: Grupo Espanol De Tratamiento De Tumores De Cabeza Y Cuello (Hospital/Clinic/Other health care facility). Phase: Therapeutic exploratory (Phase II). Countries: Spain (ongoing, recruiting).
Therapeutic area(s): Diseases [C] - Neoplasms [C04]
Gender: Female, Male. Age: 18-64 years, 65+ years. Enrolment: 65.
Status: Ongoing, recruiting. Start date (EU): 2025-05-20. Decision date: 2025-02-25. Results received: No. Last updated: 2026-02-20.

Condition(s): Recurrent/Metastatic Squamous Cell Carcinoma of the Head and Neck
Product: Paclitaxel Teva 6 mg/ml concentrado para solución para perfusión EFG, Erbitux 5 mg/mL solution for infusion

Primary endpoint: Objective response rate (ORR) according to RECIST V1.1 criteria
Endpoint(s): DCR, Median PFS, Median OS, Health-related quality of life (HRQoL), assessed through the European Organization for Research and Treatment of Cancer Quality of Life Questionnaire C30 (EORTC QLQ-C30) version 3, the head and neck specific module QLQ-H&N35 and EuroQol EQ-5D., Frequency and severity of adverse events and Treatment-related adverse events (TRAEs) assessed by NCI CTCAE v5.0, Rate of completion of C2D8, C4D8 and C6D8 of Cetuximab +/- Paclitaxel

Source: https://euclinicaltrials.eu/ctis-public/view/2024-514953-31-00